EU clinical trial 2025-523589-26-00: Infusion of Furosemide to Improve Diuretic Efficiency in Acute Heart Failure (INFUSE-AHF)
Protocol code: INFUSE-AHF
Sponsor: Region Midtjylland (Hospital/Clinic/Other health care facility). Phase: Therapeutic use (Phase IV). Countries: Denmark (ongoing, recruiting).
Therapeutic area(s): Diseases [C] - Cardiovascular Diseases [C14]
Gender: Female, Male. Age: 18-64 years, 65+ years. Enrolment: 436.
Status: Ongoing, recruiting. Start date (EU): 2026-06-30. Decision date: 2026-04-24. Results received: No. Last updated: 2026-04-24.

Condition(s): Acute heart failure with volume overload
Product: FUROSEMIDE

Primary endpoint: Net weight loss 3 days (≈72 hours) after randomisation
Endpoint(s): Net weight loss 2 days (≈48 hours) after randomisation, Change in dyspnea on a Visual Analogue Scale 3 days (≈72 hours) after randomisation, Days alive out-of-hospital to Day 30, Length of stay

Source: https://euclinicaltrials.eu/ctis-public/view/2025-523589-26-00